EU clinical trial 2023-503378-19-00: A Phase 3, Multicenter, Randomized, Placebo- and Active Comparator-Controlled Study Evaluating the Efficacy, Safety, and Pharmacokinetics of Subcutaneously Administered Guselkumab for the Treatment of Chronic Plaque Psoriasis in Pediatric Participants (≥6 To <18 Years of Age)
Sponsor: Janssen - Cilag International (Pharmaceutical company). Phase: Therapeutic confirmatory (Phase III). Countries: Germany (ongoing, recruitment ended), Hungary (ongoing, recruitment ended), Belgium (ongoing, recruitment ended), Italy (ongoing, recruitment ended), Poland (ongoing, recruitment ended).
Therapeutic area(s): Diseases [C] - Immune System Diseases [C20]
Gender: Female, Male. Age: 0-17 years. Enrolment: 97.
Status: Ongoing, recruitment ended. Start date (EU): 2018-08-23. Decision date: 2024-01-17. Results received: No. Last updated: 2026-01-15.
Decision dates by country: BE: 2024-01-25, HU: 2024-01-18, DE: 2024-01-17, IT: 2024-01-22, PL: 2024-02-05

Condition(s): Chronic Plaque Psoriasis
Product: Enbrel 50 mg solution for injection in pre-filled syringe, Guselkumab - solution for injection in pre-filled syringe - 100 mg/mL, Guselkumab 1 mL PFS Placebo, Guselkumab, Guselkumab 0.5 mL Varioject Placebo, Enbrel 25 mg powder and solvent for solution for injection

Primary endpoint: The proportion of participants with a PASI 75 response at Week 16.

Source: https://euclinicaltrials.eu/ctis-public/view/2023-503378-19-00